EU clinical trial 2024-518966-28-00: The effects of belimumab on synovial inflammation and composition of lymph nodes in SLE patients
Sponsor: Amsterdam UMC Stichting (Patient organisation/association). Phase: Therapeutic use (Phase IV). Countries: Netherlands (authorised, recruiting).
Therapeutic area(s): Diseases [C] - Immune System Diseases [C20]; Diseases [C] - Skin and Connective Tissue Diseases [C17]
Gender: Female, Male. Age: 18-64 years, 65+ years. Enrolment: 10.
Status: Authorised, recruiting. Start date (EU): 2024-11-25. Decision date: 2024-11-25. Results received: No. Last updated: 2026-06-08.

Condition(s): Systemic lupus erythematodes
Product: Benlysta 200 mg solution for injection in pre-filled pen.

Primary endpoint: the change in the composition of B lineage cells in the peripheral blood and lymph nodes. These will be separate co-primary endpoints. We will investigate the differences between SLE patients treated with belimumab compared to SLE patients treated with other drugs, expecting a more profound effect in patients treated with belimumab.
Endpoint(s): Correlation between changes in B lineage cells in peripheral blood/tissues and clinical response. Alterations in the B cell lineage will be related to clinical response (defined as a >4 point improvement in cSLEDAI or any improvement in BILAG-2004 score) in a 2x2 chi-square test for all patients. Further secondary and exploratory outcomes are changes in B lineage cells and associated (pathogenic) T cell subsets in lymph nodes of SLE patients in comparison to the changes in the peripheral blood

Source: https://euclinicaltrials.eu/ctis-public/view/2024-518966-28-00